EU clinical trial 2025-520529-19-00: A phase 1 Clinical Trial to Evaluate Safety and Immunogenecity of HIV SOSIP v8.2 763 Vaccine in healthy individuals
Protocol code: HIVIC-FOUND
Sponsor: Consorcio Centro De Investigacion Biomedica En Red (Laboratory/Research/Testing facility). Phase: Human Pharmacology (Phase I)- First administration to humans. Countries: Spain (ended).
Therapeutic area(s): Diseases [C] - Virus Diseases [C02]
Gender: Female, Male. Age: 18-64 years. Enrolment: 12.
Status: Ended. Start date (EU): 2026-05-20. End date (EU): 2026-05-21. Decision date: 2025-01-16. Results received: No. Last updated: 2025-01-16.

Condition(s): Human Immunodeficiency Virus (HIV)

Source: https://euclinicaltrials.eu/ctis-public/view/2025-520529-19-00